EU clinical trial 2025-523879-34-00: An open-label, randomized, single-dose, three-way crossover trial to evaluate the pharmacokinetics of nicotine pouch (NP) dry 4 mg compared with Nicorette® lozenge 4 mg in healthy adults who use cigarettes
Protocol code: SM25-01
Sponsor: Swedish Match North Europe AB (Pharmaceutical company). Phase: Human Pharmacology (Phase I)- Bioequivalence Study. Countries: Sweden (ended).
Therapeutic area(s): Psychiatry and Psychology [F] - Behavior and Behavior Mechanisms [F01]
Gender: Female, Male. Age: 18-64 years. Enrolment: 72.
Status: Ended. Start date (EU): 2025-11-17. End date (EU): 2026-02-06. Decision date: 2025-11-17. Results received: No. Last updated: 2025-11-17.

Condition(s): Nicotine use

Source: https://euclinicaltrials.eu/ctis-public/view/2025-523879-34-00